EU clinical trial 2024-510635-21-00: A phase 3, randomized, double-blind, study to assess efficacy and safety of ianalumab (VAY736) versus placebo in warm autoimmune hemolytic anemia (wAIHA) patients who failed at least one line of treatment (VAYHIA)
Protocol code: CVAY736O12301
Sponsor: Novartis Pharma AG (Pharmaceutical company). Phase: Therapeutic confirmatory (Phase III). Countries: Germany (ongoing, recruitment ended), Hungary (ongoing, recruitment ended), Italy (ended), Romania (ended), Spain (ongoing, recruitment ended), France (ongoing, recruitment ended).
Therapeutic area(s): Diseases [C] - Hemic and Lymphatic Diseases [C15]
Gender: Female, Male. Age: 18-64 years, 65+ years. Enrolment: 32.
Start date (EU): 2023-05-09. Decision date: 2024-07-12. Results received: No. Last updated: 2026-03-30.
Decision dates by country: RO: 2024-07-30, HU: 2024-07-15, ES: 2024-07-15, IT: 2024-07-22, FR: 2024-07-16, DE: 2024-07-12

Condition(s): warm autoimmune haemolytic anaemia (wAIHA)
Product: ERYTHROPOIETIN, DANAZOL, VAY736, ENTECAVIR, Placebo to VAY736 150 mg/1 mL concentrate for solution for infusion

Primary endpoint: Binary variable indicating whether a patient achieves a durable response (Hb ≥10 g/dL and ≥2 g/dL increase from baseline), for a period of at least 8 weeks, between W9 and W25, in the absence of rescue or prohibited treatment
Endpoint(s): Duration of response, Time from randomization to achievement of durable response, to first response, to first complete response, Response rate, complete response rate and hemoglobin level, Number and proportion of participants that receive rescue treatment overall and by type of rescue treatment, Time-standardized numbers of each type of rescue treatment, Change from baseline in time-standardized number of transfusions, Frequency of AEs and other safety parameters, Ianalumab concentration in serum and PK parameters after the first and last dose, B-cell levels: • Change from baseline in the frequency and absolute number of CD19+ B-cell counts • Time to first occurrence of B-cell recovery, defined as ≥80% of baseline or ≥50 cells/μL, Immunoglobulins: • Change from baseline in immunoglobulin levels, Incidence and titer of anti-drug antibodies (ADA) in serum over time, Change from baseline in dedicated Patient Reported Outcomes (PROs)

Source: https://euclinicaltrials.eu/ctis-public/view/2024-510635-21-00